EU clinical trial 2023-510184-35-00: A multi-center, open, randomized, 18-month, parallel-group, superiority study to compare the effect of proactive therapeutic drug monitoring versus standard of care with regards to maintenance of sustained disease control without flare in adults with rheumatoid arthritis treated with a subcutaneous tumor necrosis factor inhibitor
Sponsor: Diakonhjemmet Sykehus AS, Medical University Of Vienna, Karolinska University Hospital, University Of Medicine And Pharmacy Carol Davila Bucharest, Humanitas Mirasole S.p.A. (Hospital/Clinic/Other health care facility, Educational Institution, Hospital/Clinic/Other health care facility, Educational Institution, Hospital/Clinic/Other health care facility). Phase: Therapeutic use (Phase IV). Countries: Norway (ongoing, recruitment ended), Sweden (ongoing, recruitment ended), Austria (ongoing, recruitment ended), Romania (ongoing, recruitment ended), Italy (ongoing, recruitment ended).
Therapeutic area(s): Diseases [C] - Musculoskeletal Diseases [C05]
Gender: Female, Male. Age: 18-64 years. Enrolment: 410.
Status: Ongoing, recruitment ended. Start date (EU): 2024-08-20. Decision date: 2024-05-21. Results received: No. Last updated: 2026-05-11.
Decision dates by country: AT: 2024-11-18, RO: 2024-10-24, SE: 2024-05-24, IT: 2025-09-12, NO: 2024-05-21

Condition(s): Rheumatoid arthritis
Product: Yuflyma 40 mg solution for injection in pre-filled pen, Hyrimoz 40 mg solution for injection in pre-filled pen, Hefiya 40 mg solution for injection in pre-filled pen, Humira 40 mg solution for injection in pre-filled syringe, Humira 40 mg solution for injection in pre-filled pen, Hefiya 40 mg solution for injection in pre-filled syringe, Yuflyma 40 mg solution for injection in pre-filled syringe, Yuflyma 40 mg solution for injection in pre-filled syringe, Hyrimoz 40 mg solution for injection in pre-filled syringe, Hulio 40 mg solution for injection in pre-filled syringe, AMGEVITA 40 mg solution for injection in pre-filled pen, Hefiya 40 mg solution for injection in pre-filled syringe, Humira 40 mg solution for injection in pre-filled syringe, Hyrimoz 40 mg solution for injection in pre-filled syringe, Idacio 40 mg solution for injection in pre-filled syringe, Hulio 40 mg solution for injection in pre-filled syringe, Hyrimoz 40 mg solution for injection in pre-filled syringe, Hukyndra 40 mg solution for injection in pre-filled syringe, Hyrimoz 40 mg solution for injection in pre-filled pen, Hukyndra 40 mg solution for injection in pre-filled pen, AMGEVITA 40 mg solution for injection in pre-filled syringe, Imraldi 40 mg solution for injection in pre-filled pen, AMGEVITA 40 mg solution for injection in pre-filled syringe, Hefiya 40 mg solution for injection in pre-filled pen, Imraldi 40 mg solution for injection in pre-filled syringe, Humira 40 mg solution for injection in pre-filled pen, Imraldi 40 mg solution for injection in pre-filled pen, Hulio 40 mg solution for injection in pre-filled pen, Idacio 40 mg solution for injection in pre-filled pen, AMGEVITA 40 mg solution for injection in pre-filled pen, Hulio 40 mg solution for injection in pre-filled pen, Libmyris 40 mg solution for injection in pre-filled pen, Libmyris 40 mg solution for injection in pre-filled pen

Primary endpoint: Sustained disease control over the follow-up period of 18 months without flare, with flare defined as either of the following: A combination of an increase in Disease Activity Score using 28 joints- C-reactive protein (DAS28-CRP) ≥ 1.2, or ≥ 0.6 if DAS28-CRP ≥ 3.2, AND ≥ 2 swollen joints on examination of 44 joints Consensus between participant and physician that disease flare has occurred, leading to a major change in treatment
Endpoint(s): Disease activity at 4, 8, 12, and 18 months, Time to disease flare, Number and type of adverse events (AE), Drug survival, drug consumption, occurrence of ADAb, serum drug levels

Source: https://euclinicaltrials.eu/ctis-public/view/2023-510184-35-00